EU clinical trial 2023-503948-13-00: A Phase I study to evaluate the Pharmacokinetics and Safety of Letrozole LEBE in Healthy Post-menopausal Women.
Sponsor: Laboratorios Farmaceuticos Rovi S.A. (Pharmaceutical company). Phase: Human Pharmacology (Phase I)- Other. Countries: Czechia (ended), Bulgaria (ended).
Therapeutic area(s): Diseases [C] - Neoplasms [C04]
Gender: Female. Age: 18-64 years, 65+ years. Enrolment: 105.
Status: Ended. Start date (EU): 2023-07-20. End date (EU): 2026-03-11. Decision date: 2023-07-12. Results received: No. Last updated: 2026-03-24.
Decision dates by country: CZ: 2023-07-12, BG: 2025-02-13

Condition(s): Healthy Post-menopausal women.

Source: https://euclinicaltrials.eu/ctis-public/view/2023-503948-13-00